EU clinical trial 2022-503040-41-00: An international prospective open-label, multi-center, randomized, non-comparative phase II study of lutetium [177Lu] vipivotide tetraxetan (AAA617) alone and lutetium [177Lu] vipivotide tetraxetan (AAA617) in combination with androgen receptor pathway inhibitors in patients with PSMA PET scan positive castration-resistant prostate cancer (PSMACare)
Protocol code: CAAA617B12203
Sponsor: Novartis Pharma AG (Pharmaceutical company). Phase: Therapeutic exploratory (Phase II). Countries: Spain (ongoing, recruitment ended), Germany (ongoing, recruitment ended), Italy (ongoing, recruitment ended), Netherlands (ended), Czechia (ongoing, recruitment ended), France (ongoing, recruitment ended), Poland (ongoing, recruitment ended).
Therapeutic area(s): Diseases [C] - Neoplasms [C04]
Gender: Male. Age: 18-64 years, 65+ years. Enrolment: 45.
Start date (EU): 2024-02-09. Decision date: 2023-12-04. Results received: No. Last updated: 2025-12-16.
Decision dates by country: CZ: 2023-12-06, DE: 2023-12-05, PL: 2023-12-04, FR: 2024-04-04, ES: 2023-12-04, IT: 2023-12-05, NL: 2023-12-05

Condition(s): PSMA PET scan positive Castration-Resistant Prostate Cancer (CRPC)
Product: DEGARELIX ACETATE, ENZALUTAMIDE, DEGARELIX, ENZALUTAMIDE, DAROLUTAMIDE, RELUGOLIX, ENZALUTAMIDE, Locametz 25 micrograms kit for radiopharmaceutical preparation, Pluvicto 1 000 MBq/mL solution for injection/infusion, APALUTAMIDE

Primary endpoint: PSA response rate is defined as the proportion of participants who have a post-baseline PSA nadir value of ≤0.2ng/mL that is confirmed by a second (the next) PSA measurement ≥4 weeks later.
Endpoint(s): MFS is defined as the time from date of randomization to first evidence of radiographically detectable bone or soft tissue distant metastasis by conventional imaging (i.e., CT/MRI and bone scans) as assessed by investigator using RECIST 1.1 or death due to any cause, whichever occurs first, rPFS is defined as the time from the date of randomization to the date of first documented radiographic disease progression by conventional imaging (i.e., CT/MRI and bone scans) as assessed by investigator using RECIST 1.1 or death due to any cause, whichever occurs first, OS is defined as the time from the date of randomization to the date of death due to any cause, PFS2 defined as time from the date of randomization to the date of first documented disease progression by investigator's assessment (PSA, radiographic, symptomatic, or any combination) on next line of therapy subsequent to MFS event or death due to any cause, whichever occurs first, Time to symptomatic progression will be defined as the time from the date of randomization to the date of first documented event for any of the following, whichever occurs first • Development of a symptomatic skeletal event (SSE) • Pain progression or worsening of disease-related symptoms requiring initiation of a new systemic anti-cancer therapy, Time to initiation of cytotoxic chemotherapy will be defined as the time from the date of randomization to the date of first documented dose of new cytotoxic chemotherapy being administered to the participant, Time to first SSE (TTSSE) defined as the time from the date of randomization to the date of the first new symptomatic pathological bone fracture, spinal cord compression, tumor-related orthopedic surgical intervention, requirement for radiation therapy to relieve bone pain or death due to any cause, whichever occurs first, Time to distant metastasis development is defined as the time from the date of randomization to the date of first evidence of radiographically detectable bone or soft tissue distant metastasis by conventional imaging (i.e., CT/MRI and bone scans) as assessed by investigator using RECIST 1.1, Time to local radiological progression is defined as the time from the date of randomization to the date of first documented local radiographic disease progression by conventional imaging (i.e., CT/MRI and bone scans) as assessed by investigator using RECIST 1.1, Time to initiation or change in therapy will be defined as the time from the date of randomization to the date of first documented dose of a new / change in therapy being administered to the participant, Time from the date of randomization to the date of first documented PSA progression according to PCWG3 guideline criteria. PCWG3 has defined PSA progression as an increase in PSA greater than 25% and >2 ng/ml above nadir, confirmed by progression at 2 timepoints at least 3 weeks apart, Calculated as the time from the date of randomization to the date of first documented PSA response with a PSA nadir value of ≤0.2ng/mL, PSA50 response is defined as the proportion of participants who have a ≥50% decrease in PSA from baseline that is confirmed by a second (the next) PSA measurement ≥4 weeks later, PSA90 response is defined as the proportion of participants who have a ≥90% decrease in PSA from baseline that is confirmed by a second (the next) PSA measurement ≥4 weeks later, HRQoL as assessed by Functional Assessment of Cancer Therapy Prostate (FACT-P), Brief Pain Inventory Short From (BPI-SF),) and Functional Assessment of Cancer Therapy (FACT-RNT), Safety: incidence and severity of AEs and serious adverse events (SAEs), changes in laboratory values, vital signs, and ECGs. Any clinically significant lab, vital signs, ECG abnormalities will be captured as an AE. Tolerability: dose interruptions, reductions and dose intensity.

Source: https://euclinicaltrials.eu/ctis-public/view/2022-503040-41-00